EU clinical trial 2024-518438-94-00: C4921003 - A Phase 2, Randomized, Double-Blind, Placebo-Controlled Study to Evaluate the Efficacy and Safety of an Oral Branched-Chain Ketoacid Dehydrogenase Kinase Inhibitor, PF-07328948 in Adults with Heart Failure (BRANCH-HF)
Protocol code: C4921003
Sponsor: Pfizer Inc. (Pharmaceutical company). Phase: Therapeutic exploratory (Phase II). Countries: France (ongoing, recruiting), Spain (ongoing, recruiting), Bulgaria (ongoing, recruiting), Poland (ongoing, recruiting), Hungary (ongoing, recruiting), Czechia (ongoing, recruiting).
Therapeutic area(s): Diseases [C] - Cardiovascular Diseases [C14]
Gender: Female, Male. Age: 18-64 years, 65+ years. Enrolment: 356.
Status: Ongoing, recruiting. Start date (EU): 2025-10-24. Decision date: 2025-10-08. Results received: No. Last updated: 2026-06-29.
Decision dates by country: ES: 2025-10-09, PL: 2025-10-10, BG: 2025-10-10, FR: 2025-10-10, HU: 2025-10-13, CZ: 2025-10-08

Condition(s): Heart failure
Product: Placebo for pf-07328948 tablet (CCI) mg, Placebo for pf-07328948 tablet (CCI) mg

Primary endpoint: Hierarchical combination of: • Adjudicated clinical events through Week 36: CV death, WHF event resulting in hospitalization, WHF event resulting in intravenous diuretic during an urgent HF visit, WHF event resulting in oral diuretic intensification in an outpatient setting. • CFB in 6MWD at Week 36 • CFB in KCCQ-23 TSS at Week 36.
Endpoint(s): • Incidence of TEAEs and TESAEs., • CFB in KCCQ-23 TSS, CSS, and physical limitation at Week 36., • CFB in 6MWD at Week 36. • CPET substudy only: CFB in pVO2 at Week 36., • CFB in NT-proBNP at Week 36.

Source: https://euclinicaltrials.eu/ctis-public/view/2024-518438-94-00